EU clinical trial 2023-506327-29-00: A Phase 3 Randomized Double-blind Study of Adjuvant Pembrolizumab With or Without V940 in Participants With Resectable Stage II to IIIB (N2) NSCLC not Achieving pCR After Receiving Neoadjuvant Pembrolizumab With Platinum-based Doublet Chemotherapy (INTerpath-009)
Protocol code: V940-009
Sponsor: Merck Sharp & Dohme LLC (Pharmaceutical company). Phase: Therapeutic confirmatory (Phase III). Countries: Spain (ongoing, recruiting), Hungary (ongoing, recruiting), Italy (ongoing, recruiting), Finland (ongoing, recruiting), France (ongoing, recruiting), Romania (ongoing, recruiting), Germany (ongoing, recruiting), Ireland (ongoing, recruiting), Netherlands (ongoing, recruiting), Sweden (ongoing, recruiting), Belgium (ongoing, recruiting), Poland (ongoing, recruiting), Bulgaria (ongoing, recruiting), Greece (ongoing, recruiting).
Therapeutic area(s): Diseases [C] - Neoplasms [C04]
Gender: Female, Male. Age: 18-64 years, 65+ years. Enrolment: 260.
Status: Ongoing, recruiting. Start date (EU): 2025-05-14. Decision date: 2024-11-18. Results received: No. Last updated: 2026-06-04.
Decision dates by country: IT: 2024-11-21, FI: 2024-11-22, ES: 2024-11-18, BE: 2024-11-21, GR: 2024-11-18, SE: 2024-11-21, DE: 2024-11-20, RO: 2024-11-22, NL: 2024-11-25, IE: 2024-11-22, BG: 2024-11-25, PL: 2024-11-24, HU: 2024-11-22, FR: 2024-11-21

Condition(s): Non-Small Cell Lung Cancer
Product: CISPLATIN, PACLITAXEL, GEMCITABINE, CARBOPLATIN, placebo for mRNA-4157, PEMETREXED, mRNA-4157, KEYTRUDA 25 mg/mL concentrate for solution for infusion, KEYTRUDA 25 mg/mL concentrate for solution for infusion

Primary endpoint: Disease- Free Survival (DFS)
Endpoint(s): Overall survival (OS), Distant Metastasis-Free Survival (DMFS), Disease- Free Survival 2 (DFS2), Lung Cancer Specific Survival (LCSS), Change from Baseline in the European Organization for Research and Treatment of Cancer (EORTC)-Quality of Life Questionnaire-Core 30 (QLQ-C30) Global Health Status/Quality of Life (Items 29 and 30), Change from Baseline in the EORTC QLQ-C30 Physical Functioning (Items 1-5), Change from Baseline in the EORTC QLQ-C30 Role Functioning (Items 6 and 7), Number of participants with ≥1 adverse event (AE), Number of participants discontinuing from study therapy due to AE(s)

Source: https://euclinicaltrials.eu/ctis-public/view/2023-506327-29-00